EU clinical trial 2023-507093-40-00: A Phase IIb, Randomized, Double-Blind, Placebo-Controlled, Multicenter Study to Evaluate the Efficacy and Safety of Astegolimab in Patients with Chronic Obstructive Pulmonary Disease
Protocol code: GB43311
Sponsor: Genentech Inc. (Pharmaceutical company). Phase: Therapeutic exploratory (Phase II). Countries: France (ended), Romania (ended), Denmark (ended), Czechia (ended), Belgium (ended), Poland (ended), Sweden (ended), Spain (ended), Germany (ended), Bulgaria (ended), Netherlands (ended).
Therapeutic area(s): Phenomena and Processes [G] - Immune System Phenomena [G13]; Diseases [C] - Respiratory Tract Diseases [C08]
Gender: Female, Male. Age: 18-64 years, 65+ years. Enrolment: 613.
Status: Ended. Start date (EU): 2022-01-27. End date (EU): 2025-02-07. End date: 2025-07-07. Decision date: 2024-04-02. Results received: Yes. Last updated: 2025-06-18.
Decision dates by country: DE: 2024-04-08, DK: 2024-04-03, NL: 2024-04-02, RO: 2024-04-04, BG: 2024-04-23, SE: 2024-04-03, CZ: 2024-04-03, BE: 2024-04-11, FR: 2024-04-15, ES: 2024-04-04, PL: 2024-04-19

Condition(s): Chronic Obstructive Pulmonary Disease (COPD)

Primary endpoint: 1. Annualized rate of moderate and severe COPD exacerbations over the 52-week treatment period
Endpoint(s): 1.Time to first moderate or severe COPD exacerbation during the 52-week treatment period, 2. Absolute change from baseline in HRQoL at Week 52, as assessed through the St. George's Respiratory Questionnaire-COPD (SGRQ-C) total score, 3. Proportion of patients with improvement in HRQoL, defined as a decrease from baseline of >/=4 points in SGRQ-C total score, at Week 52, 4. Absolute change from baseline in post-bronchodilator FEV1 (liters) at Week 52, 5. Absolute change from baseline in Evaluating Respiratory Symptoms in COPD (E-RS:COPD) total score at Week 52, 6. Annualized rate of severe COPD exacerbations over the 52-week treatment period, 7. Absolute change from baseline in five-repetition sit-to-stand test (5STS) time (seconds) at Week 52, 8. Incidence and severity of adverse events, 9. Serum concentration of astegolimab at specified timepoints, 10. Prevalence of anti-drug antibodies (ADAs) at baseline and incidence of ADAs during the study

Source: https://euclinicaltrials.eu/ctis-public/view/2023-507093-40-00